EU clinical trial 2024-518731-11-00: Impact of beta blocker administration on outcome among patients undergoing transcatheter aortic valve replacement - B-TAVR
Protocol code: NCT06472934
Sponsor: Universitaetsspital Basel (Hospital/Clinic/Other health care facility). Phase: Therapeutic use (Phase IV). Countries: Austria (ongoing, recruiting), Germany (ongoing, recruiting).
Therapeutic area(s): Diseases [C] - Cardiovascular Diseases [C14]
Gender: Female, Male. Age: 18-64 years, 65+ years. Enrolment: 400.
Status: Ongoing, recruiting. Start date (EU): 2025-08-04. Decision date: 2025-07-07. Results received: No. Last updated: 2026-04-24.
Decision dates by country: AT: 2025-07-07, DE: 2025-07-15

Condition(s): Aortic stenosis

Primary endpoint: Composite endpoint of all-cause mortality, rehospitalization due to heart failure, stroke, severe arrhythmia (new onset atrial fibrillation/flutter, ventricular tachycardia/ventricular fibrillation, new high-grade AV-Block) at 30 days
Endpoint(s): Pacemaker Rate at 30 days and at 1 year, Stroke Rate at 30 days and at 1 year, All-cause mortality at 30 days and 1 year, Cardiovascular mortality at 30 days and 1 year, Re-hospitalization due to heart failure at 30 days and 1 year, Severe arrhythmia requiring treatment (e.g.: new onset atrial fibrillation/flutter, ventricular tachycardia /ventricular fibrillation, new AV Block (I, II or III), new left bundle branch block, new right bundle branch block, intraventricular conduction delay (QRS ≥120ms), new severe bradycardia (HR <60 bpm) requiring treatment or tachycardia (‹40bpm or ›120bpm), sick sinus syndrome, new tachycardia (HR>120 bpm) at 30 days and at 1 year

Source: https://euclinicaltrials.eu/ctis-public/view/2024-518731-11-00